EU clinical trial 2024-511254-51-00: Safety and Tolerability of a Timolol Releasing Intraocular Implant in Subjects With Primary Open-angle Glaucoma
Protocol code: EyeD-010-003
Sponsor: Eyed Pharma (Pharmaceutical company). Phase: Human Pharmacology (Phase I)- First administration to humans. Countries: Belgium (ended), Germany (ended).
Therapeutic area(s): Diseases [C] - Eye Diseases [C11]
Gender: Female, Male. Age: 18-64 years, 65+ years. Enrolment: 18.
Status: Ended. Start date (EU): 2023-02-09. End date (EU): 2025-06-26. Decision date: 2024-05-10. Results received: No. Last updated: 2024-12-16.
Decision dates by country: BE: 2024-06-07, DE: 2024-05-10

Condition(s): Glaucoma

Source: https://euclinicaltrials.eu/ctis-public/view/2024-511254-51-00